EU clinical trial 2022-500305-40-00: HOVON 165 CLL: A prospective randomized phase I/II trial of venetoclax treatment (26 cycles) with 6 cycles or 12 cycles of epcoritamab in patients with relapsed or refractory chronic lymphocytic leukemia or Small Lymphocytic Lymphoma. AETHER study (ABT199 + Epcoritamab THErapy for Relapsed/refractory CLL/SLL)
Protocol code: HO165
Sponsor: Stichting Hemato-Oncologie voor Volwassenen Nederland (Hovon) (Hospital/Clinic/Other health care facility). Phase: Phase I and Phase II (Integrated)- Other. Countries: Belgium (ongoing, recruiting), Netherlands (ongoing, recruiting), Germany (ongoing, recruiting), Denmark (ongoing, recruiting).
Therapeutic area(s): Diseases [C] - Neoplasms [C04]
Gender: Female, Male. Age: 18-64 years, 65+ years. Enrolment: 112.
Status: Ongoing, recruiting. Start date (EU): 2024-04-10. Decision date: 2024-01-15. Results received: No. Last updated: 2026-06-22.
Decision dates by country: NL: 2024-01-15, BE: 2024-01-16, DK: 2024-01-16, DE: 2024-01-16

Condition(s): Chronic Lymphocytic Leukemia, Small Lymphocytic Lymphoma
Product: Venetoclax, Epcoritamab (GEN3013), Epcoritamab (GEN3013), Venetoclax, Venetoclax

Primary endpoint: Phase I: recommended Phase 2 Dose (RP2D) for the combination of venetoclax and epcoritamab based on dose limiting toxicity (DLT)., Phase II: undetectable minimal residual disease <10-4 (uMRD4) in the bone marrow (BM), i.e., less than 1 CLL cell per 10 000 leukocytes (equivalently: <0.01%, or <10-4), in absence of progression according to the IWCLL criteria, at 12 weeks after the last day, i.e., day 28, of cycle 26.
Endpoint(s): MRD status in PB at cycle 4, 6, 9, 12, 15, 18, 21, 24 and 12 weeks after day 28 of cycle 26; following treatment: every 3 months for the first year, then every 6 months until relapse or until 6 years after randomization., Progression free survival (PFS), defined as time from randomization to the first occurrence of disease progression or death from any cause, whichever occurs first., Overall survival (OS), defined as the time from randomization to death from any cause., Best overall response rate (ORR) defined as the proportion of patients with a complete response (CR), complete response with incomplete marrow recovery (CRi), or partial response (PR) according to IWCLL 2018 criteria., Event free survival (EFS), defined as time from randomization to date of start of next CLL treatment, progression or death, whichever comes first., Time to next CLL treatment (TTNT), defined as time from randomization to next new line of treatment., Treatment free survival (TFS), defined as time from date of last protocol treatment to date start of next (new) line of treatment, or death from any cause, whichever comes first., Duration of response (DOR), defined as time from first response (i.e., ≥PR and CR) to progressive disease (PD) or death from any cause.., Depth (level) of MRD measured in BM after cycle 9 and 12 weeks after day 28 of cycle 26., Depth (level) of MRD measured in PB at cycle 4, 6, 9, 12, 15, 18, 21, 24, 12 weeks after day 28 of cycle 26 and thereafter every 3 months for the first year, then every 6 months until relapse or until 6 years after registration., Safety parameters: Type, frequency, and severity of- adverse events (AEs) and- adverse events of special interest (AESI) and their relationship to study treatment (determined according to National Cancer Institute (NCI) Common Terminology Criteria for Adverse Events (CTCAE) v5.0)., Health-related quality of life (QoL) by EORTC QLQ-C30, QLQ-CLL17 and PRO-CTCAE questionnaires., Evaluation of relationship between various baseline markers and clinical outcome parameters (response, MRD, EFS, etc), Immunophenotyping and functional T cell studies., Circulating tumor DNA study on several time points., Baseline molecular characteristics (IGHV mutation status, TP53 mutations, genomic complexity)., Retrospective exploratory analysis to investigate the effect of epcoritamab in combination with venetoclax on immune composition, genomic and transcriptomic profiles and clonal repertoire., Association between MRD (after cycle 9 and 12 weeks after cycle 26) in PB and BM, and PFS/OS., Immune markers in relation to CRS and infections.

Source: https://euclinicaltrials.eu/ctis-public/view/2022-500305-40-00